EU clinical trial 2024-519260-41-00: Effects of combined oral contraceptives on brain and behavior
Sponsor: Paris Lodron Universitaet Salzburg (Educational Institution). Phase: Therapeutic use (Phase IV). Countries: Austria (ongoing, recruitment ended).
Therapeutic area(s): Phenomena and Processes [G] - Reproductive and Urinary Physiological Phenomena [G08]
Gender: Female. Age: 0-17 years, 18-64 years. Enrolment: 600.
Status: Ongoing, recruitment ended. Start date (EU): 2020-07-15. Decision date: 2024-12-09. Results received: No. Last updated: 2025-11-12.

Condition(s): Hormonal contraception
Product: BILINDA GYNIAL 0,03 mg/2 mg Filmtabletten, Selina Gynial 0,03 mg/0,15 mg Filmtabletten

Primary endpoint: Mood and self-perception (Premenstrual symptoms, Positive and negative affect, depression, Anxiety, Gender Role), Cognition (Face recognition, verbal fluency, navigation, working memory), Brain structure, Brain function
Endpoint(s): sex hormone levels (estradiol, progesterone, allopregnanolone, testosterone dihydrotestosterone, LH, FSH, Prolactin, SHBG), stress hormone levels (cortisol, ACTH), levels of interventional drugs (Ethinylestradiol, Levonorgestrel, Chlormadinonacetate), Genetic variants (repeat polymorphism or SNP) of steroid hormone receptors (AR, ESR1, ESR2, PGR, MR) targeted by the interventional drugs, Genetic variants of genes (repeat polymorphism or SNP) involved in neurotransmitter systems (COMT, MAOA, 5HTT, 5HTR, BDNF) responsive to sex hormones

Source: https://euclinicaltrials.eu/ctis-public/view/2024-519260-41-00